EU clinical trial 2026-525575-22-00: A first in human study of the safety, pharmacokinetics and pharmacodynamics of KLR-003 in healthy participants and patients with immune mediated diseases.
Protocol code: KLR003-Clin-004
Sponsor: Klear Bio Inc. (Pharmaceutical company). Phase: Human Pharmacology (Phase I)- First administration to humans. Countries: Netherlands (ongoing, recruiting).
Therapeutic area(s): Diseases [C] - Skin and Connective Tissue Diseases [C17]; Diseases [C] - Immune System Diseases [C20]
Gender: Female, Male. Age: 18-64 years. Enrolment: 182.
Status: Ongoing, recruiting. Start date (EU): 2026-05-07. Decision date: 2026-04-30. Results received: No. Last updated: 2026-07-08.

Condition(s): Psoriasis

Source: https://euclinicaltrials.eu/ctis-public/view/2026-525575-22-00